EU clinical trial 2025-523123-22-00: J2A-MC-GZPW: A Phase 3, Randomized, Double-Blind, Placebo-Controlled, Event-Driven Study to Investigate the Effect of Orforglipron on the Incidence of Major Adverse Cardiovascular Events in Participants With Established Atherosclerotic Cardiovascular Disease and/or Chronic Kidney Disease
Protocol code: J2A-MC-GZPW
Sponsor: Eli Lilly & Co. (Pharmaceutical company). Phase: Therapeutic confirmatory (Phase III). Countries: Germany (ongoing, recruiting), Czechia (ongoing, recruiting), Lithuania (ongoing, recruiting), Spain (ongoing, recruiting), Austria (ongoing, recruiting), France (ongoing, recruiting), Hungary (ongoing, recruiting), Greece (ongoing, recruiting), Estonia (ongoing, recruiting), Netherlands (ongoing, recruiting), Slovakia (ongoing, recruiting), Poland (ongoing, recruiting), Romania (ongoing, recruiting), Bulgaria (ongoing, recruiting), Italy (ongoing, recruiting), Belgium (ongoing, recruiting).
Therapeutic area(s): Diseases [C] - Cardiovascular Diseases [C14]
Gender: Female, Male. Age: 18-64 years, 65+ years. Enrolment: 1793.
Status: Ongoing, recruiting. Start date (EU): 2026-05-07. Decision date: 2026-02-24. Results received: No. Last updated: 2026-08-07.
Decision dates by country: AT: 2026-03-01, EE: 2026-03-02, FR: 2026-02-27, IT: 2026-03-02, LT: 2026-02-24, ES: 2026-02-27, PL: 2026-02-26, RO: 2026-03-02, BG: 2026-03-02, SK: 2026-02-24, GR: 2026-02-26, BE: 2026-02-24, CZ: 2026-02-24, DE: 2026-02-24, HU: 2026-03-02, NL: 2026-03-02

Condition(s): Atherosclerosis Cardiovascular Disease, Chronic Kidney Disease
Product: Orforglipron, Orforglipron, Placebo to match, Orforglipron, Orforglipron, Orforglipron, Orforglipron

Primary endpoint: Time to First Occurrence of Composite Endpoint of Major Cardiovascular Events Composite endpoint includes nonfatal myocardial infarction, nonfatal stroke, hospitalization or urgent visit due to heart failure, coronary revascularization, or all-cause death [Time Frame: Baseline up to end of study (about 5 years)]

Source: https://euclinicaltrials.eu/ctis-public/view/2025-523123-22-00